EU clinical trial 2023-503689-21-00: An Open-label, Randomized Phase Ib/II Study Evaluating Safety, Tolerability, and Clinical Activity of Forimtamig-Based Treatment Combinations in Participants with Relapsed or Refractory Multiple Myeloma
Protocol code: BP43437
Sponsor: F. Hoffmann-La Roche AG (Pharmaceutical company). Phase: Phase I and Phase II (Integrated)- Other. Countries: Spain (ended), Denmark (ended), France (ended), Germany (ended), Italy (ended).
Therapeutic area(s): Diseases [C] - Neoplasms [C04]
Gender: Female, Male. Age: 18-64 years, 65+ years. Enrolment: 73.
Status: Ended. Start date (EU): 2023-12-05. End date (EU): 2025-04-14. End date: 2025-07-08. Decision date: 2023-10-19. Results received: Yes. Last updated: 2024-10-10.
Decision dates by country: DK: 2023-10-20, FR: 2023-10-23, DE: 2023-10-24, ES: 2023-10-19, IT: 2023-10-24

Condition(s): Multiple myeloma (MM)
Product: DIPHENHYDRAMINE, ACTEMRA, RO7425781, DEXAMETHASONE, DARZALEX 1800 mg solution for injection, Kyprolis 30 mg powder for solution for infusion, RO7425781

Primary endpoint: 1. Incidence and severity of adverse events (AEs), with severity determined according to National Cancer Institute Common Terminology Criteria for Adverse Events, Version 5.0 (NCI CTCAE v5.0) and of cytokine release syndrome (CRS) and immune effector cell associated neurotoxicity syndrome (ICANS) according to American Society of Transplantation and Cellular Therapy (ASTCT) Consensus Grading, 2. Objective response rate (ORR), 3. Complete response (CR)/stringent complete response (sCR) rate, 4. Rate of very good partial response (VGPR) or better
Endpoint(s): 1. Progression-free survival (PFS), 2. Duration of response (DoR) for participants who achieve a partial response (PR) or better, 3. Time to first response, 4. Time to best response, 5. Overall survival (OS), 6. To assess the serum concentrations and PK parameters of forimtamig, 7. Presence of anti-drug antibodies (ADAs) during the study

Source: https://euclinicaltrials.eu/ctis-public/view/2023-503689-21-00